EU clinical trial 2023-505624-56-00: An Open Label, Randomized, Multicenter, Active-Controlled, Parallel-Group Study to Evaluate the Safety, Tolerability, and Efficacy of BIIB017 in Pediatric Subjects Aged 10 to Less than 18 Years for the Treatment of Relapsing Remitting Multiple Sclerosis, with Optional Open-Label Extension (105MS306)
Protocol code: 105MS306
Sponsor: Biogen Idec Research Limited (Pharmaceutical company). Phase: Therapeutic confirmatory (Phase III). Countries: Slovakia (ended), Bulgaria (ended), Hungary (ongoing, recruitment ended), Croatia (ended), Czechia (ended).
Therapeutic area(s): Diseases [C] - Nervous System Diseases [C10]
Gender: Female, Male. Age: 0-17 years. Enrolment: 29.
Start date (EU): 2019-08-07. Decision date: 2024-11-04. Results received: No. Last updated: 2025-09-11.
Decision dates by country: BG: 2024-11-08, HR: 2024-11-05, CZ: 2024-11-08, SK: 2024-11-05, HU: 2024-11-04

Condition(s): Relapsing Remitting Multiple Sclerosis (RRMS)
Product: Plegridy 125 micrograms solution for injection in pre-filled pen, AVONEX 30 micrograms/0.5ml solution for injection in pre-filled pen., Plegridy 63 micrograms+94 micrograms solution for injection in pre-filled pen, AVONEX 30 micrograms/0.5 ml solution for injection.

Primary endpoint: Part 1: the annualized relapse rate (ARR) at Week 48., Part 2: Percentage of Participants with Adverse Events (AEs), Serious Adverse Events (SAEs) and AEs leading to Study Treatment Discontinuation. [From Week 96 to week 196]
Endpoint(s): [Part I] ARR at week 48, [Part I] Percentage of Participants Free of New or Newly Enlarging T2 Hyperintense Lesions on Brain Magnetic Resonance Imaging (MRI) Scans at Weeks 24, 48, and 96, [Part I] Percentage of Participants Free of New MRI Activity in the Brain (Free of Gadolinium [Gd]-Enhancing Lesions and New or Newly Enlarging T2 Hyperintense Lesions) at Weeks 24, 48, and 96, [Part I] Number of New or Newly Enlarging T2 Hyperintense Lesions on Brain MRI Scans at Weeks 24, 48, and 96, [Part I] Number of Gd-Enhancing Lesions on Brain MRI Scans at Weeks 24, 48, and 96, [Part I] Time to First Relapse (timeframe: Up to week 96)., [Part I] Percentage of Participants Free of Relapse at Weeks 48 and 96., [Part I] Change from Baseline in Cognition at Weeks 24, 48, 72, and 96 as Measured by the Symbol Digit Modality Test (SDMT), [Part I] Change from Baseline in the Expanded Disability Status Scale (EDSS) Score at Weeks 48 and 96, [Part I] Change from Baseline in the Quality of Life as Measured by the Pediatric Quality of Life Inventory (PedsQL) at Weeks 24, 48, 72 and 96, [Part I] Area Under the Plasma Concentration-Time Curve from Time Zero to End of Dosing Interval (AUCtau) for BIIB017. [Time Frame: Within 8 hours postdose on Day 1 of Week 1; Within 8 hours, 48 and 120 hours postdose on Day 1 of Week 4; Within 8 hours postdose on Day 1 of Week 24], [Part I] Part 1: Maximum Observed Plasma Concentration (Cmax) at Steady State for BIIB017 Within 8 hours postdose on Day 1 of Week 1; Within 8 hours, 48 and 120 hours postdose on Day 1 of Week 4; Within 8 hours postdose on Day 1 of Week 24, [Part I] Time to Reach Maximum Observed Plasma Concentration (Tmax) at Steady State for BIIB017 Within 8 hours postdose on Day 1 of Week 1; Within 8 hours, 48 and 120 hours postdose on Day 1 of Week 4; Within 8 hours postdose on Day 1 of Week 24, [Part I] Percentage of Participants With Adverse Events (AEs), Serious Adverse Events (SAEs), and AEs Leading to Study Treatment Discontinuation (timeframe up to week 100), [Part I] Change from Baseline in Height at Weeks 24, 48, 72, 96, and 100, [Part I] Change from Baseline in Weight at Weeks 24, 48, 72, 96, and 100, [Part I] Number of Participants With Binding and Neutralizing Antibodies to Interferon Beta Type 1a (IFN β-1a) [All Participants] [Time Frame: Up to Week 96], [Part I] Number of Participants With Binding Antibodies to Peginterferon (PEG) [BIIB017-Treated Participants] Anti-PEG binding antibodies in human serum will be determined using an ELISA (Timeframe: Up to Week 96), [Part I] Change from Baseline in Depression as Assessed by Mini International Neuropsychiatric Interview for Children and Adolescents (MINI-KID) at Weeks 12, 24, 36, 48, 60, 72, 84, 96, and 100, [Part I] Change from Baseline in Blood Pressure at Weeks 4, 8, 12, 24, 36, 48, 60, 72, 84, 96, and 10, [Part I] Change from Baseline in Pulse Rate at Weeks 4, 8, 12, 24, 36, 48, 60, 72, 84, 96, and 100, [Part I] Change from Baseline in Body Temperature at Weeks 4, 8, 12, 24, 36, 48, 60, 72, 84, 96, and 100, [Part I] Change from Baseline in Respiratory Rate at Weeks 4, 8, 12, 24, 36, 48, 60, 72, 84, 96, and 100, [Part I] Change from Baseline in 12-Lead Electrocardiogram (ECG) Parameters at Weeks 48, 96, and 100, [Part I] Percentage of Participants with Changes Over Time in Clinical Laboratory Values at Baseline & Weeks 4, 8, 12, 24, 36, 48, 60, 72, 84, 96, and 100, Part 2: ARR at Weeks 144 and 192, Part 2: Change from Baseline in EDSS Score at Weeks 120, 144, 168, 192, and 196, Part 2: Change from Baseline in Height at Weeks 120, 144, 168, 192, and 196, Part 2: Change from Baseline in Weight at Weeks 120, 144, 168, 192, and 196, Part 2: Change from Baseline in Tanner Score at Weeks 120, 144, 168, 192, and 196, Part 2: Number of Participants With Binding and Neutralizing Antibodies to IFN β-1a (All Participants) (Time Frame: Up to week 192), Part 2: Number of Participants With Binding Antibodies to PEG (BIIB017-Treated Participants) (Time Frame: Up to week 192), Part 2: Change from Baseline in Blood Pressure at Weeks 120,144,168, 192, and 196, Part 2: Change from Baseline in Pulse Rate at Weeks 120, 144, 168, 192, and 196, Part 2: Change from Baseline in Body Temperature at Weeks 120, 144, 168, 192, and 196, Part 2: Change from Baseline in Respiratory Rate at Weeks 120, 144, 168, 192, and 196, Part 2: Change from Baseline in 12-Lead ECG Parameters at Weeks 144, 192, and 196, Part 2: Change from Baseline in Depression as Assessed by Mini International Neuropsychiatric Interview for Children and Adolescents (MINI-KID) at Weeks 108, 120, 132, 144,156, 168, 180, 192, and 196, Part 2: Percentage of Participants with Changes Over Time in Clinical Laboratory Values at Baseline & (Week 96), Weeks 108, 120, 132, 144, 156, 168, 180, 192, and 196

Source: https://euclinicaltrials.eu/ctis-public/view/2023-505624-56-00